EU clinical trial 2026-526263-38-00: A trial in healthy participants to find out how long JNJ-101556143 stays in and acts on the body when administered as different formulations and under different food conditions
Protocol code: 101556143PCR1001
Sponsor: Janssen Cilag International (Pharmaceutical company). Phase: Human Pharmacology (Phase I)- Other. Countries: Belgium (ongoing, recruiting).
Therapeutic area(s): Diseases [C] - Neoplasms [C04]
Gender: Male. Age: 18-64 years. Enrolment: 48.
Status: Ongoing, recruiting. Start date (EU): 2026-06-19. Decision date: 2026-06-09. Results received: No. Last updated: 2026-07-17.

Condition(s): Prostate Cancer

Source: https://euclinicaltrials.eu/ctis-public/view/2026-526263-38-00